EU clinical trial 2024-512019-36-00: A first-in-human clinical study to assess safety and tolerability of genetically modified T-cells in ROR1 positive tumors
Protocol code: LION-1
Sponsor: Universitaetsklinikum Wuerzburg AöR (Hospital/Clinic/Other health care facility). Phase: Human Pharmacology (Phase I)- First administration to humans. Countries: Germany (ongoing, recruiting).
Therapeutic area(s): Diseases [C] - Neoplasms [C04]
Gender: Female, Male. Age: 18-64 years, 65+ years. Enrolment: 44.
Status: Ongoing, recruiting. Start date (EU): 2025-04-09. Decision date: 2024-07-19. Results received: No. Last updated: 2026-04-13.

Condition(s): Adrenocortical carcinoma, Breast cancer, Chronic lymphocytic leukemia, Ovarian cancer, Mantle cell lymphoma

Source: https://euclinicaltrials.eu/ctis-public/view/2024-512019-36-00